EU clinical trial 2024-511684-28-00: Long-term follow-up of patients previously treated with autologous T cells genetically modified with viral vectors.
Protocol code: AUTO-LT1
Sponsor: Autolus Limited (Pharmaceutical company). Phase: Therapeutic exploratory (Phase II). Countries: Spain (ongoing, recruiting).
Therapeutic area(s): Diseases [C] - Immune System Diseases [C20]; Diseases [C] - Neoplasms [C04]
Gender: Female, Male. Age: 0-17 years, 18-64 years, 65+ years. Enrolment: 21.
Status: Ongoing, recruiting. Start date (EU): 2025-09-01. Decision date: 2024-07-19. Results received: No. Last updated: 2026-03-18.

Condition(s): Potential malignancy in patients who received treatment with Autolus CAR T cell therapy.
Product: AUTO1, MabThera 500 mg concentrate for solution for infusion, AUTO4, MabThera 100 mg concentrate for solution for infusion

Primary endpoint: Incidence of serious adverse events related to AUTO CAR T cell therapy, New malignancies, Other designated adverse events of special interest related to AUTO CAR T cell therapy
Endpoint(s): Overall survival for up to 15 years after the first AUTO CAR T cell therapy infusion, Duration of supportive care, Duration of response, progression-free survival, Proportion of patients with detectable vector copy number in peripheral blood for up to 15 years from first AUTO CAR T cell therapy infusion, Confirm / monitor for absence of detectable RCR/RCL for up to 15 years from first AUTO CAR T cell therapy infusion, In case of new malignancy: Insertion site analysis to determine insertional mutagenesis as potential cause/contributor

Source: https://euclinicaltrials.eu/ctis-public/view/2024-511684-28-00